EU clinical trial 2024-510824-38-00: A clinical study to evaluate the efficacy of ceritinib in combination with nivolumab in patients with ALK positive lung cancer
Protocol code: CLDK378A2120C
Sponsor: Novartis Pharma AG (Pharmaceutical company). Phase: Human Pharmacology (Phase I)- Other. Countries: Belgium (ongoing, recruitment ended), Spain (ongoing, recruitment ended).
Therapeutic area(s): Diseases [C] - Neoplasms [C04]
Gender: Female, Male. Age: 18-64 years, 65+ years. Enrolment: 23.
Status: Ongoing, recruitment ended. Start date (EU): 2015-05-27. Decision date: 2024-04-09. Results received: No. Last updated: 2026-02-24.
Decision dates by country: BE: 2024-04-22, ES: 2024-04-09

Condition(s): Non-small cell lung cancer

Source: https://euclinicaltrials.eu/ctis-public/view/2024-510824-38-00